EU clinical trial 2024-512698-29-00: TSPO ligands in the treatment of depression: proof-of-concept of efficacy and underlying mechanisms of action
Protocol code: TSPOC5FOR2022
Sponsor: Medizinische Einrichtungen des Bezirks Oberpfalz KU AöR (Hospital/Clinic/Other health care facility). Phase: Therapeutic exploratory (Phase II). Countries: Germany (ended).
Therapeutic area(s): Psychiatry and Psychology [F] - Mental Disorders [F03]
Gender: Female, Male. Age: 18-64 years, 65+ years. Enrolment: 50.
Status: Ended. Start date (EU): 2024-07-25. End date (EU): 2025-11-21. Decision date: 2024-07-25. Results received: No. Last updated: 2025-06-26.

Condition(s): Unipolar/bipolar depressive disorder
Product: Capsule, hard; oral use; Apart from the active substances the placebo is identical to the IMP, STRESAM, gélule

Primary endpoint: ET50 estimated based on the HAMD-21 scores assessed at the baseline and days 1, 2, 3, 4, 5, 6, 7, 8, 15, 22 and 29 after start of the treatment
Endpoint(s): HAMD-21 score at baseline and on days 1, 2, 3, 4, 5, 6, 7, 8, 15, 22 and 29 after start of the treatment, PHQ-9 score at baseline and on days 1, 2, 3, 4, 5, 6, 7, 8, 15, 22 and 29 after start of the treatment, VAS-scores at baseline and on days 1, 2, 3, 4, 5, 6, 7, 8, 15, 22 and 29 after start of the treatment, BDI-score at baseline and on days 8, 15, 22 and 29 after start of treatment, HAM-A score at baseline and on days 8, 15, 22 and 29 after start of treatment, MADRS score at baseline and on days 1, 2, 3, 4, 5, 6, 7, 8, 15, 22 and 29 after start of the treatment, SSS score at baseline and on days 8, 15, 22 and 29 after start of treatment, C-SSRs score at baseline and on days 8, 15, 22 and 29 after start of treatment, Adverse events on days 1, 8, 15, 22 and 29 after start of treatment, Neurosteroids in serum (pregnenolone, progesterone, 5α-dihydroprogesterone, allopregnanolone, epipregnanolone, pregnanolone, corticosterone, deoxycorticosterone) at baseline and on day 15 after start of treatment, TSPO expression in thrombocytes at baseline and on day 15 after start of treatment, Cortisol Awakening Response (CAR) at baseline and on day 15 after start of treatment measured in saliva directly as well as 30 and 60 minutes after awakening, Cognitive functions assessed with the CANTAB test battery at baseline and on day 15 after start of treatment, Amplitude changes of the blood oxygenation level in fMRI signal (BOLD) during a learning task at baseline and on day 15 and 29 after start of treatment, Representational dissimilarity of emotional stimuli at baseline and on day 15 and 29 after start of treatment, Functional connectivity and connectivity dynamics at baseline and on day 15 and 29 after start of treatment, Alpha diversity (number of species in one habitat) of the microbiome at baseline and on day 15 and 29 after start of treatment, Beta diversity (development of the number of species in one habitat) of the microbiome at baseline and on day 15 and 29 after start of treatment, Odour capacity quantified by the SDI-score at baseline and on day 15 and 29 after start of treatment

Source: https://euclinicaltrials.eu/ctis-public/view/2024-512698-29-00